EU clinical trial 2023-508530-34-00: EPIK-P2: A Phase II double-blind study with an upfront, 16-week randomized, placebo-controlled period, to assess the efficacy, safety and pharmacokinetics of alpelisib (BYL719) in pediatric and adult patients with PIK3CA-related overgrowth spectrum (PROS)
Protocol code: CBYL719F12201
Sponsor: Novartis Pharma AG (Pharmaceutical company). Phase: Therapeutic exploratory (Phase II). Countries: Netherlands (ongoing, recruitment ended), Spain (ongoing, recruitment ended), Norway (ongoing, recruitment ended), Germany (ongoing, recruitment ended), France (ongoing, recruitment ended), Italy (ongoing, recruitment ended).
Therapeutic area(s): Diseases [C] - Congenital, Hereditary, and Neonatal Diseases and Abnormalities [C16]
Gender: Female, Male. Age: 0-17 years, 18-64 years, 65+ years. Enrolment: 164.
Status: Ongoing, recruitment ended. Start date (EU): 2021-04-19. Decision date: 2024-08-07. Results received: No. Last updated: 2026-04-15.
Decision dates by country: ES: 2024-08-09, IT: 2024-09-09, FR: 2024-08-12, NO: 2024-08-07, DE: 2024-08-09, NL: 2024-10-14

Condition(s): PIK3CA-Related Overgrowth Spectrum (PROS)
Product: Placebo to BYL719 50 mg film-coated tablets (Light Yellow); Placebo to BYL719 125 mg film-coated tablets (Dark Yellow), BYL719, BYL719, BYL719, BYL719, BYL719

Primary endpoint: Response (yes/no) defined by achieving at least 20% reduction from baseline in the sum of target lesion volumes (1 to 3 lesions, assessed by MRI by a blinded independent review committee (BIRC)), provided that none of the individual target lesions has ≥ 20% increase from baseline and in absence of progression of non-target lesions and without new lesions.
Endpoint(s): The key secondary objective is to demonstrate the efficacy of alpelisib based on the comparison of the proportion of participants achieving response at Week 16 with alpelisib versus placebo in Groups 1 or 2.

Source: https://euclinicaltrials.eu/ctis-public/view/2023-508530-34-00